EU clinical trial 2022-501893-21-00: Rituximab in patients with ST-elevation myocardial infarction. A phase 2 placebo controlled randomized clinical trial. RITA-MI 2
Sponsor: Assistance Publique Hopitaux De Paris (Hospital/Clinic/Other health care facility). Phase: Therapeutic exploratory (Phase II). Countries: France (ongoing, recruiting), Spain (ongoing, recruiting), Germany (ongoing, recruiting), Czechia (ongoing, recruiting), Netherlands (authorised, recruitment pending).
Therapeutic area(s): Diseases [C] - Cardiovascular Diseases [C14]
Gender: Female, Male. Age: 18-64 years, 65+ years. Enrolment: 416.
Start date (EU): 2022-05-03. Decision date: 2022-10-06. Results received: No. Last updated: 2026-07-22.
Decision dates by country: NL: 2024-03-25, CZ: 2023-03-06, FR: 2022-10-06, ES: 2022-12-19, DE: 2023-04-24

Condition(s): Acute myocardial infarction, ST segment elevation myocardial infarction
Product: SODIUM CHLORIDE, MabThera 500 mg concentrate for solution for infusion

Primary endpoint: The primary endpoint is the left ventricular ejection fraction (LVEF) by CMR at 6 months.
Endpoint(s): • Infarct size by CMRI (using T1-weighted late gadolinium enhancement, LGE) between day 3 and day 7 (5±2) and at 6 months., Oedema extension by CMRI (using T2W) between day 3 and day 7 (5±2), T2 relaxation time at ischemic region by CMRI (using T2 mapping) between day 3 and day 7 (5±2), Microvascular obstruction by CMRI (hypointense areas within LGE) between day 3 and day 7 (5±2), NT-pro-BNP at 6 months, Any adverse event related to treatment

Source: https://euclinicaltrials.eu/ctis-public/view/2022-501893-21-00